EU clinical trial 2024-516339-28-00: A phase 2a multicentric study of TAR-0520 gel in EGFR inhibitor-induced folliculitis
Protocol code: TARIAN 007
Sponsor: Tarian Pharma (Pharmaceutical company). Phase: Therapeutic exploratory (Phase II). Countries: France (authorised, recruiting).
Therapeutic area(s): Diseases [C] - Skin and Connective Tissue Diseases [C17]
Gender: Female, Male. Age: 18-64 years, 65+ years. Enrolment: 60.
Status: Authorised, recruiting. Start date (EU): 2025-02-10. Decision date: 2024-11-13. Results received: No. Last updated: 2026-03-13.
Decision dates by country: FR: 2024-12-17

Condition(s): EGFR inhibitor-induced folliculitis
Product: TAR-0520 gel matching vehicle without active ingredients, TAR-0520 Gel

Primary endpoint: Incidence of Adverse Events, Adverse Events of Special Interest and Serious Adverse Events
Endpoint(s): Modified folliculitis CTCAE, Facial folliculitis severity score, Modified FACT-EGFRI-18 questionnaire

Source: https://euclinicaltrials.eu/ctis-public/view/2024-516339-28-00